EU clinical trial 2022-501684-40-00: A Phase 1 Study to Evaluate the Safety, Tolerability, and Preliminary Efficacy of Denikitug (GS-1811), an Afucosylated Anti-CCR8 Monoclonal Antibody, as Monotherapy and in Combination With an Anti–PD-1 Monoclonal Antibody in Adults With Advanced Solid Tumors
Protocol code: GS-US-570-6015
Sponsor: Gilead Sciences Inc. (Pharmaceutical company). Phase: Human Pharmacology (Phase I)- Other. Countries: Spain (ongoing, recruiting), Belgium (ended).
Therapeutic area(s): Diseases [C] - Neoplasms [C04]
Gender: Female, Male. Age: 18-64 years, 65+ years. Enrolment: 93.
Start date (EU): 2023-10-05. Decision date: 2023-07-06. Results received: No. Last updated: 2026-04-13.
Decision dates by country: BE: 2023-07-06, ES: 2023-07-18

Condition(s): Head and Neck Squamous Cell Carcinoma, Non-Small-Cell Lung Cancer, Gastric and Esophagogastric Junction Adenocarcinoma, Microsatellite Stable Metastatic Colorectal Cancer

Source: https://euclinicaltrials.eu/ctis-public/view/2022-501684-40-00